EU clinical trial 2023-505755-40-00: (22040 ALPINE 1) A Phase 2b dose-finding, randomized, placebo-controlled, double-blind study to evaluate efficacy and safety of BAY 3283142 on top of standard of care in reducing albuminuria in patients with chronic kidney disease
Protocol code: 22040
Sponsor: Bayer AG (Pharmaceutical company). Phase: Therapeutic exploratory (Phase II). Countries: Belgium (ended), Sweden (ended), Spain (ended), Italy (ended), Portugal (ended), Slovakia (ended), Greece (ended).
Therapeutic area(s): Diseases [C] - Cardiovascular Diseases [C14]
Gender: Female, Male. Age: 18-64 years, 65+ years. Enrolment: 557.
Status: Ended. Start date (EU): 2024-08-16. End date (EU): 2025-11-14. End date: 2025-11-20. Decision date: 2024-08-06. Results received: No. Last updated: 2025-12-15.
Decision dates by country: IT: 2024-08-08, SK: 2024-08-15, SE: 2024-08-07, GR: 2024-08-22, BE: 2024-08-07, ES: 2024-08-20, PT: 2024-08-06

Condition(s): Chronic kidney disease
Product: BAY 3283142, BAY 3283142 PLACEBO, BAY 3283142, BAY 3283142

Primary endpoint: Change from baseline to Week 16 in the logarithm of urine albumin-creatinine ratio (UACR)
Endpoint(s): Change from baseline over time (Visits 5, 6 and 7) in estimated glomerular filtration rate (eGFR), Change from baseline over time (Visits 5, 6 and 7) in the logarithm of UACR, Number of subjects with treatment-emergent adverse events (TEAEs), serious TEAEs, and TEAEs leading to permanent discontinuation of study intervention

Source: https://euclinicaltrials.eu/ctis-public/view/2023-505755-40-00